EU clinical trial 2024-510602-90-00: COTAM - Use of glucocorticoids therapy in acute myocarditis with severe left ventricular dysfunction: a multicenter randomized controlled trial
Protocol code: APHP230855
Sponsor: Assistance Publique Hopitaux De Paris (Hospital/Clinic/Other health care facility). Phase: Therapeutic confirmatory (Phase III). Countries: France (authorised, recruitment pending).
Therapeutic area(s): Diseases [C] - Cardiovascular Diseases [C14]
Gender: Female, Male. Age: 18-64 years, 65+ years. Enrolment: 420.
Status: Authorised, recruitment pending. Decision date: 2025-03-20. Results received: No. Last updated: 2025-08-04.

Condition(s): Patients presenting with acute myocarditis proven by cardiac magnetic resonance imaging (CMRi) or by histological evidence on endomyocardial biopsy (EMB)
Product: Methylprednisolone 500 mg powder and solvent for solution for injection/infusion, Placebo of methylprednisolone (glucose 5%), placebo of prednisone, PREDNISONE ARROW 20 mg, comprimé sécable

Primary endpoint: Major Cardiovascular Events (MACE) and/or persistence of left ventricular dysfunction defined as LVEF < 50% and/or Global Longitudinal Strain (GLS) < - 16% between baseline (D-2) and 6 months (M6) follow up. MACE is a combined criterion that includes all-cause mortality, heart failure hospitalization, sustained ventricular arrhythmia, heart transplantation or assistance and recurrent acute myocarditis with LV dysfunction at 6 months
Endpoint(s): Changes in LVEF ≥ 50% at 6 months using 2D trans-thoracic echocardiography (2D-TTE) between baseline (D-2 maximum) and 6 months (M6), Changes in Global Longitudinal Strain (GLS) ≥ -16% at 6 months using 2D-TTE between baseline (D-2 maximum) and 6 months (M6), All-cause mortality, Hospitalization for heart failure, Sustained ventricular arrhythmia, Heart transplantation, Heart assistance by extracorporeal membrane oxygenation (ECMO), Intra-aortic balloon pump (IABP), Impella device or Left Ventricular Assistance Devices (LVAD), Time to recurrence of acute myocarditis with LV dysfunction, Adverse events and serious adverse events especially nosocomial infectious and duration of treatment by insulin, Compliance to the treatment (premature ending of the treatment or proportion of non-administered doses of the treatment), Increased quality of life evaluated by Minnesota living with heart failure questionnaire (MLHFQ) during follow up

Source: https://euclinicaltrials.eu/ctis-public/view/2024-510602-90-00